EU clinical trial 2024-519910-30-00: Lantiolihaspuudutuksen vaikutus munuaisen poistoleikkauksen jälkeiseen kivun hoitoon ja toipumiseen
Protocol code: QLB-N-2017
Sponsor: Pirkanmaan hyvinvointialue (Hospital/Clinic/Other health care facility). Phase: Therapeutic use (Phase IV). Countries: Finland (authorised, recruitment pending).
Therapeutic area(s): Diseases [C] - Neoplasms [C04]
Gender: Female, Male. Age: 18-64 years, 65+ years. Enrolment: 90.
Status: Authorised, recruitment pending. Decision date: 2025-01-21. Results received: No. Last updated: 2025-01-21.

Condition(s): Renal cancer
Product: Ropivacain Fresenius Kabi 7,5 mg/ml injektioneste, liuos, Dexamethasone Kabi 4 mg/ml solution for injection/infusion, Natriumchloride Fresenius Kabi 100 mg/ml (10%), concentraat voor oplossing voor infusie

Primary endpoint: kumulatiivinen opiaatin kulutus 1, 2, 4, 8, 12, 16 ja 24 tuntia puudutuksen jälkeen
Endpoint(s): Aika puudutuksen laitosta ensimmäisen kipulääkkeen tarpeeseen, kipu levossa/liikkeellä

Source: https://euclinicaltrials.eu/ctis-public/view/2024-519910-30-00